EU clinical trial 2024-518404-44-00: First-in-Human Dose Study of IOA-244 in patients with advanced or metastatic cancers.
Protocol code: IOA-244-101
Sponsor: iOnctura SA (Pharmaceutical company). Phase: Human Pharmacology (Phase I)- First administration to humans. Countries: Italy (authorised, recruitment pending).
Therapeutic area(s): Diseases [C] - Neoplasms [C04]
Gender: Female, Male. Age: 18-64 years, 65+ years. Enrolment: 34.
Status: Authorised, recruitment pending. Decision date: 2024-12-16. Results received: No. Last updated: 2026-07-15.

Condition(s): Advanced solid tumours and metastatic cancers

Source: https://euclinicaltrials.eu/ctis-public/view/2024-518404-44-00